EU clinical trial 2023-506690-36-00: A Phase 1/2a Dose-Escalating Study to Evaluate the Safety, Tolerability, Pharmacokinetics, and Pharmacodynamics of ARO-C3 in Adult Healthy Volunteers and in Adult Patients With Complement-Mediated Renal Disease
Protocol code: AROC3-1001
Sponsor: Arrowhead Pharmaceuticals Inc. (Pharmaceutical company). Phase: Phase I and Phase II (Integrated)- Other. Countries: Germany (ended).
Therapeutic area(s): Diseases [C] - Immune System Diseases [C20]
Gender: Female, Male. Age: 18-64 years, 65+ years. Enrolment: 5.
Status: Ended. Start date (EU): 2024-05-06. End date (EU): 2025-09-04. End date: 2025-09-10. Decision date: 2023-12-07. Results received: No. Last updated: 2025-08-15.

Condition(s): complement-mediated renal disease
Product: ARO-C3

Primary endpoint: Incidence, frequency, and severity of treatment-emergent adverse events (TEAEs)
Endpoint(s): Plasma PK of ARO-C3, Changes and percent change from baseline in serum complement component (C) 3 (C3) at scheduled visits

Source: https://euclinicaltrials.eu/ctis-public/view/2023-506690-36-00